EU clinical trial 2023-509862-39-00: A Phase 1 relative bioavailability study in 14 healthy adult participants investigating the Arvisol® tablets to see whether its pharmacokinetic properties are similar to the reference drug which is a marketed oral soliton cannabidiol, named Epidiolex® CBD oral solution.
Protocol code: ARV-BA-001
Sponsor: Echo Pharmaceuticals B.V. (Pharmaceutical company). Phase: Human Pharmacology (Phase I)- Bioequivalence Study. Countries: Hungary (ended).
Therapeutic area(s): Diseases [C] - Nervous System Diseases [C10]
Gender: Female, Male. Age: 18-64 years, 65+ years. Enrolment: 14.
Status: Ended. Start date (EU): 2024-02-23. End date (EU): 2024-04-04. Decision date: 2024-02-19. Results received: No. Last updated: 2024-02-19.

Condition(s): Healthy volunteers

Source: https://euclinicaltrials.eu/ctis-public/view/2023-509862-39-00